EU clinical trial 2024-517082-16-01: Immediate versus delayed insertion of intrauterine contraception at the time of medical abortion- An open-label, randomized, multicenter study
Sponsor: Karolinska Institutet (Educational Institution). Phase: Therapeutic confirmatory (Phase III). Countries: Sweden (authorised, recruitment pending).
Therapeutic area(s): Not possible to specify
Gender: Female. Age: 18-64 years. Enrolment: 720.
Status: Authorised, recruitment pending. Decision date: 2024-10-09. Results received: No. Last updated: 2024-10-09.

Condition(s): Post medical abortion contraception
Product: Mirena 20 mikrogram/24 timmar intrauterint inlägg, Kyleena® 19,5 mg, intrauterint inlägg, Jaydess 13,5 mg, intrauterint inlägg

Primary endpoint: The proportion of women in each group (immediate or delayed) using intrauterine contraception as contraception at 6 months post abortion
Endpoint(s): Use of IUC at 3, 6 and 12 months post insertion evaluated by telephone or e-mail follow-up (continued use/voluntary discontinued use, involuntary discontinued use including expulsions etc) reasons for discontinuation will be recorded and subsequent use of other contraceptive methods will be noted), Difference in the proportion of women who successfully have the IUC inserted (success versus failure),, Ease of insertion according to health care provider (judged as very easy, easy, moderately, or very difficult), pain at time of insertion (women will indicate the pain before insertion, at placement of tenaculum, sound and IUC by putting a vertical mark on a 10 cm long horizontal line with a Visual Analogue Scale (VAS) from 0, indicating no pain to 10 indicating worst imaginable pain. Result will be noted in millimeters and entered into case report forms)., Post-abortion bleeding (number of days of fresh bleeding and spotting after the abortion), Reasons for non-attempted insertion of IUC (change of mind, heavy bleeding, not coming for insertion, staff being unavailable etc),, Pregnancies occurring during the 6 and 12 month follow-up (planned and unplanned, wanted and unwanted, pregnancy outcomes- ectopic, miscarriage, abortion, molar, kept pregnancy),, Acceptability of immediate and delayed insertion of IUC by asking women if they would recommend the procedure to a friend (yes/no, asked at the time of insertion and at the 3 and 6 month follow up),, Acceptability of IUC as post abortion contraception- evaluated as above,, Expulsion rate during 12 months following insertion in both groups evaluated by telephone follow up at 3, 6 and 12 months post abortion (complete, partial or no expulsion. The exact day of expulsion will be noted to determine the risk of expulsion as a function of time post insertion),, Complications (adverse events (AE) and serious AE) bleeding requiring any treatment, uterine perforations and cervical tears, infection requiring treatment with antibiotics, hospitalization for any reason, surgical procedures due to heavy bleeding, incomplete abortions, prolonged bleeding or patient request,, The proportion of surgical procedures in total and for each study site (type of procedure, reasons therefore- infection, retained products of conception, prolonged bleeding etc).

Source: https://euclinicaltrials.eu/ctis-public/view/2024-517082-16-01